EU clinical trial 2024-515961-33-00: The Neurobiological Effect of 5-HT2AR Modulation
Protocol code: 2016-004000-61
Sponsor: Rigshospitalet (Hospital/Clinic/Other health care facility). Phase: Human Pharmacology (Phase I)- Other. Countries: Denmark (ongoing, recruiting).
Therapeutic area(s): Analytical, Diagnostic and Therapeutic Techniques and Equipment [E] - Investigative Techniques [E05]
Gender: Female, Male. Age: 18-64 years, 65+ years. Enrolment: 240.
Status: Ongoing, recruiting. Start date (EU): 2024-09-02. Decision date: 2024-09-02. Results received: No. Last updated: 2025-12-12.

Condition(s): No medical conditions or diseases will be examined, only healthy volunteers will participate.

Source: https://euclinicaltrials.eu/ctis-public/view/2024-515961-33-00